EU clinical trial 2024-511964-95-00: Dapagliflozin in the treatment of decompensated liver cirrhosis: phase IIb randomised, controlled clinical trial
Protocol code: SWEET LIVER
Sponsor: Azienda Ospedale-Universita Padova (Hospital/Clinic/Other health care facility). Phase: Therapeutic exploratory (Phase II). Countries: Italy (ongoing, recruiting).
Therapeutic area(s): Diseases [C] - Digestive System Diseases [C06]
Gender: Female, Male. Age: 18-64 years, 65+ years. Enrolment: 110.
Status: Ongoing, recruiting. Start date (EU): 2025-07-28. Decision date: 2024-06-27. Results received: No. Last updated: 2025-05-05.

Condition(s): Decompensated liver cirrhosis
Product: Forxiga 10 mg film-coated tablets

Primary endpoint: Incidence of global adverse events and incidence of serious adverse events.
Endpoint(s): Composite endpoints of further decompensation of cirrhosis (occurrence of variceal bleeding, hepatic encephalopathy, new-onset ascites or recurrent ascites, hepatorenal syndrome, spontaneous bacterial peritonitis) and death assessed at day 28 (± 7), 56 (± 7), 84 (± 7), 112 (± 7), 140 (± 7), and 168 (± 7), Incidence of new onset ascites, Incidence of recurrent ascites, Incidence of hepatic encephalopathy, Incidence of variceal bleeding, Incidence of hepatorenal syndrome, Incdencde of spontaneous bacterial peritonitis, Change from baseline in MELD score, MELD-Na score, and Child-Pugh score at day 28 (± 7), 56 (± 7), 84 (± 7), 112 (± 7), 140 (± 7), and 168 (± 7), Change in EQ-5D quality of life questionnaire score at day 84 (± 7) and 168 (± 7), Change in Liver Frailty index at day 28 (± 7), 56 (± 7), 84 (± 7), 112 (± 7), 140 (± 7) and 168 (± 7), Change from baseline in creatinine and estimated glomerular filtrate values at day 28 (± 7), 56 (± 7), 84 (± 7), 112 (± 7), 140 (± 7) and 168 (± 7), Incidence of acute over chronic liver failure, Change from baseline in 24-hour sodiuria at day 28 (± 7), day 84 (± 7) and 168 (± 7)., Change from baseline in body weight at day 28 (± 7), 56 (± 7), 84 (± 7), 112 (± 7), 140 (± 7) and 168 (± 7)., Change from baseline in proinflammatory cytokines (IL1beta, IL6, IL8, IL10, TNF-alpha, IL1ra) at day 84 (± 7) and 168 (± 7)., Change from baseline in markers of circulatory dysfunction (renin, aldosterone, copeptin) at day 84 (± 7) and 168 (± 7)., Change from baseline in markers of oxidative stress (oxidized albumin isoforms HNA1 and HNA2, thiobarbituric acid reactive substance assay) at day 84 (± 7) and 168 (± 7)., Change from baseline in markers of endothelial dysfunction (von Willebrand factor) at day 84 (± 7) and 168 (± 7)., Change from baseline in markers of liver fibrosis (PRO-C3, PRO-C6) at day 84 (± 7) and 168 (± 7),, Change from baseline in biomarkers of bacterial translocation (lipopolysaccharide binding protein, LBP) at day 84 (± 7) and 168 (± 7), Change from baseline of "DAMPs" biomarkers (mitochondrial DNA, HMGB1) at day 84 (± 7) and 168 (± 7), Change from baseline in metabolites measured by untargeted metabolomics at day 84 (± 7) and 168 (± 7)

Source: https://euclinicaltrials.eu/ctis-public/view/2024-511964-95-00